EU clinical trial 2024-517729-20-00: Extended Follow-up of Patients with Melanoma Treated with Fianlimab Plus Cemiplimab in Expansion Cohorts from R3767-ONC-1613
Protocol code: R3767-ONC-2466
Sponsor: Regeneron Pharmaceuticals Inc. (Pharmaceutical company). Phase: Therapeutic exploratory (Phase II). Countries: Ireland (authorised, recruitment pending).
Therapeutic area(s): Diseases [C] - Neoplasms [C04]
Gender: Female, Male. Age: 18-64 years, 65+ years. Enrolment: 45.
Status: Authorised, recruitment pending. Decision date: 2025-07-04. Results received: No. Last updated: 2026-06-02.

Condition(s): Melanoma
Product: LIBTAYO 350 mg concentrate for solution for infusion., Fianlimab

Primary endpoint: Death from any cause starting at time of initial treatment with fianlimab and cemiplimab in study R3767-ONC-1613
Endpoint(s): Progressive-Free Survival (PFS), Objective Response Rate (ORR), Duration of Response (DOR), Disease Control Rate (DCR), Incidence of Serious Adverse Events (SAEs), Severity of SAEs, Incidence of treatment-related AEs, Severity of treatment-related AEs, Incidence of anti-cancer therapies received since end of treatment with fianlimab and cemiplimab in study R3767-ONC-1613

Source: https://euclinicaltrials.eu/ctis-public/view/2024-517729-20-00